EU clinical trial 2026-527114-23-00: Pharmacodynamic Evaluation of OV329 in Participants with Epilepsy and a Photo-Induced Generalized Epileptiform EEG-Response Phase 2 Proof-of-Concept.
Protocol code: OV329-26-003
Sponsor: Ovid Therapeutics Inc. (Pharmaceutical company). Phase: Therapeutic exploratory (Phase II). Countries: Netherlands (authorised, recruitment pending).
Therapeutic area(s): Diseases [C] - Nervous System Diseases [C10]
Gender: Female, Male. Age: 18-64 years, 65+ years. Enrolment: 12.
Status: Authorised, recruitment pending. Decision date: 2026-08-03. Results received: No. Last updated: 2026-08-03.

Condition(s): Epilepsy
Product: OV329, OV329, Placebo for OV329

Primary endpoint: Change from Baseline in standardized photosensitivity range (SPR) on pre-dose Day 1 (placebo) to post-dose OV329 on several days

Source: https://euclinicaltrials.eu/ctis-public/view/2026-527114-23-00